EU clinical trial 2023-508010-42-00: A Phase 3, Randomized, Double-Blind, Placebo-Controlled, Multicenter Study of Niraparib Maintenance Treatment in Patients with Advanced Ovarian Cancer Following Response on Front-Line Platinum-Based Chemotherapy
Protocol code: PR-30-5017-C
Sponsor: Tesaro Inc. (Pharmaceutical company). Phase: Therapeutic confirmatory (Phase III). Countries: Ireland (ended), Spain (ended), Belgium (ended), Czechia (ended), Germany (ended), France (ended), Italy (ended), Denmark (ended), Finland (ended), Sweden (ended), Poland (ended), Hungary (ended).
Therapeutic area(s): Diseases [C] - Neoplasms [C04]
Gender: Female. Age: 18-64 years, 65+ years. Enrolment: 469.
Status: Ended. Start date (EU): 2016-09-14. End date (EU): 2025-09-30. End date: 2026-07-06. Decision date: 2024-05-13. Results received: No. Last updated: 2025-10-13.
Decision dates by country: DE: 2024-05-14, SE: 2024-05-14, HU: 2024-05-15, DK: 2024-05-13, IT: 2024-05-20, ES: 2024-05-14, FR: 2024-05-17, BE: 2024-05-17, IE: 2024-05-13, FI: 2024-05-14, PL: 2024-05-21, CZ: 2024-05-14

Condition(s): Homologous recombination deficiency advanced ovarian cancer
Product: Placebo with a matching appearance to 100 mg niraparib capsules, filled with an excipient blend for clinical development., NIRAPARIB TOSILATE MONOHYDRATE

Primary endpoint: The primary endpoint is PFS, defined as the time from treatment randomization to the earlier date of assessment of progression or death by any cause in the absence of progression.
Endpoint(s): The secondary endpoints include the following: • OS • Observed changes from baseline in the following PROs: − FOSI − EQ-5D-5L − EORTC-QLQ-C30 − EORTC-QLQ-OV28 • Time to first subsequent therapy (TFST) • PFS2

Source: https://euclinicaltrials.eu/ctis-public/view/2023-508010-42-00